EU clinical trial 2024-512797-10-00: Pomalidomide as an immune-enhancing agent for the control of HIV (PEACH): An investigator-initiated phase I/IIb clinical trial in people living with HIV on ART and during analytical treatment interruption.
Protocol code: PEACH-001
Sponsor: Region Midtjylland (Hospital/Clinic/Other health care facility). Phase: Phase I and Phase II (Integrated)- Other. Countries: Denmark (ongoing, recruiting), Spain (authorised, recruitment pending).
Therapeutic area(s): Diseases [C] - Virus Diseases [C02]
Gender: Female, Male. Age: 18-64 years, 65+ years. Enrolment: 32.
Start date (EU): 2025-02-13. Decision date: 2024-09-16. Results received: No. Last updated: 2026-07-24.
Decision dates by country: DK: 2024-09-16, ES: 2026-03-27

Condition(s): HIV-1-infection
Product: Placebo capsules, Pomalidomide

Primary endpoint: Primary safety endpoint: defined as treatment-emerging adverse events (AEs) ≥ grade 3 probably or definitely related to study treatment., Primary efficacy endpoint: The frequency of HIV-specific CD8+ T cell responses measured by intracellular cytokine staining (ICS) for IFN-γ, TNF-α, IL-2 and CD107a following stimulation of PBMCs with pools of overlapping HIV peptides
Endpoint(s): Safety defined as all other treatment-emerging AEs, graded according to severity and assessed as either not related or possibly, probably or definitely related to study treatment., HIV-specific CD4+ T cell responses by performing HIV peptide stimulation and intracellular cytokine staining (ICS) for HIV-specific T cells using flow cytometry, The frequency of peripheral blood CD4+ T cells containing total and intact HIV-DNA while on suppressive ART, The proportion of cells containing constitutive and inducible cell-associated multiply spliced HIV RNA (MS HIV-RNA) using the tat/rev induced limiting dilution assay (TILDA) while on suppressive ART, The level of cell-associated unspliced HIV RNA (CA-US HIV RNA) in peripheral blood CD4+ T cells using real-time PCR while on suppressive ART, Numbers and proportions of B cells, total lymphocytes, CD8+ T cells and CD4+ T cells including memory subsets, Viral kinetics and rebound profile in participants who participated in the analytical ART interruption that was part of PEACH protocol version 5.

Source: https://euclinicaltrials.eu/ctis-public/view/2024-512797-10-00